EU clinical trial 2022-502127-22-00: A Phase 3, Randomized, Active-Controlled, Open-Label Clinical Study to Evaluate a Switch to Doravirine/Islatravir (DOR/ISL 100 mg/0.25 mg) Once-Daily in Participants With HIV-1 Who Are Virologically Suppressed on Antiretroviral Therapy
Protocol code: MK-8591A-051
Sponsor: Merck Sharp & Dohme LLC (Pharmaceutical company). Phase: Therapeutic confirmatory (Phase III). Countries: Spain (not authorised), Italy (not authorised), France (not authorised).
Therapeutic area(s): Diseases [C] - Virus Diseases [C02]
Gender: Female, Male. Age: 18-64 years, 65+ years. Enrolment: 110.
Status: Not authorised. Decision date: 2023-04-25. Results received: No. Last updated: 2023-04-28.
Decision dates by country: FR: 2023-04-28, IT: 2023-04-28, ES: 2023-04-25

Condition(s): HIV-1 Infection
Product: Tybost 150 mg film-coated tablets

Primary endpoint: Percentage of participants with HIV-1 RNA ≥50 copies/mL at Week 48, Percentage of participants with one or more adverse events (AEs) from Day 1 up to Week 48, Percentage of participants with an AE leading to discontinuation of study intervention from Day 1 up to Week 48
Endpoint(s): Percentage of participants with HIV-1 RNA <200 copies/mL at Week 48, Percentage of participants with HIV-1 RNA <50 copies/mL at Week 48, Percentage of participants with HIV-1 RNA <200 copies/mL at Week 96, Percentage of participants with HIV-1 RNA ≥50 copies/mL at Week 96, Percentage of participants with HIV-1 RNA <50 copies/mL at Week 96, Mean change from baseline at Day 1 in CD4+ T-cell count at Week 48, Mean change from baseline at Week 48 in CD4+ T-cell count at Week 96, Mean change from baseline at Day 1 in CD4+ T-cell count at Week 96, Number of participants with viral resistance-associated substitutions, Mean change from baseline to Week 48 in fasting LDL-C, Mean change from baseline to Week 48 in fasting HDL-C, Percentage of participants with one or more AEs from Day 1 up to Week 96, Percentage of participants with an AE leading to discontinuation of study intervention from Day 1 up to Week 96, Percentage of participants with one or more AEs from Week 48 up to Week 96, Percentage of participants with an AE leading to discontinuation of study intervention from Week 48 up to Week 96

Source: https://euclinicaltrials.eu/ctis-public/view/2022-502127-22-00